EU clinical trial 2023-503790-37-00: A Phase III, Randomized, Double-Blind, Parallel Group, Multicenter Study to Compare Pharmacokinetics, Pharmacodynamics, Efficacy, Safety, and Immunogenicity of BP16 Versus EU-Prolia® in Women with Post- Menopausal Osteoporosis
Protocol code: BP16-301
Sponsor: Curateq Biologics Private Limited (Pharmaceutical company). Phase: Therapeutic confirmatory (Phase III). Countries: Latvia (ended), Estonia (ended), Slovakia (ended), Hungary (not authorised), Poland (ended), Bulgaria (ended).
Therapeutic area(s): Diseases [C] - Musculoskeletal Diseases [C05]
Gender: Female. Age: 18-64 years, 65+ years. Enrolment: 615.
Status: Ended. Start date (EU): 2024-01-09. End date (EU): 2025-12-11. End date: 2025-12-12. Decision date: 2023-11-03. Results received: No. Last updated: 2025-11-05.
Decision dates by country: HU: 2023-11-06, EE: 2023-11-06, PL: 2023-11-06, LV: 2023-11-06, SK: 2023-11-03, BG: 2023-11-06

Condition(s): Post-Menopausal Osteoporosis
Product: BP16, DENOSUMAB, CALCIUM CARBONATE, Vitamin D3 400 IU Capsules, soft

Primary endpoint: Percent change from baseline (%CfB) in lumbar spine bone mineral density (LS-BMD) at Week 52, AUEC of sCTX from Week 0 up to Week 26 (AUEC0-26w).
Endpoint(s): Percent change in bone turnover markers (sCTX and P1NP) at Week 26, Week 52, and Week 78., %CfB in LS-BMD at Week 26 and Week 78., %CfB in total hip and femoral neck BMD at Week 26, Week 52, and Week 78., Incidence of fracture up to Week 52 and Week 78., Ctrough: Serum trough concentration of denosumab at Week 26, Week 52, and Week 78., Incidence, nature, and severity of adverse events (AE) including adverse drug reactions (ADRs) graded according to Common Terminology Criteria for Adverse Events (CTCAE) v 5.0 as defined by TEAEs,SAEs, related TEAEs, and related SAEs., Physical examination, vital signs, and 12-lead ECG., Laboratory parameters (hematology, clinical chemistry, and urinalysis)., Incidence and titer of antidrug antibody to denosumab at Week 0, Week 12, Week 26, Week 52, and Week 78., Incidence of neutralizing antibody in all the ADA-positive subjects.

Source: https://euclinicaltrials.eu/ctis-public/view/2023-503790-37-00